EU clinical trial 2022-501585-22-00: A Phase 3, Randomized, 24-week, Placebo-controlled, Double-blind Study to Assess the Efficacy, Safety, and Tolerability of Rocatinlimab (AMG 451) in Combination With Topical Corticosteroids and/or Topical Calcineurin Inhibitors in Adult Subjects With Moderate-to-severe Atopic Dermatitis (AD) (ROCKET-SHUTTLE)
Protocol code: 20210144
Sponsor: Amgen Inc. (Pharmaceutical company). Phase: Therapeutic confirmatory (Phase III). Countries: Italy (ended), Netherlands (ended), Slovakia (ended), Poland (ended), Spain (ended), France (ended), Slovenia (ended), Greece (ended), Hungary (ended), Bulgaria (ended), Romania (ended), Belgium (ended), Germany (ended), Austria (ended).
Therapeutic area(s): Diseases [C] - Immune System Diseases [C20]
Gender: Female, Male. Age: 18-64 years, 65+ years. Enrolment: 307.
Status: Ended. Start date (EU): 2023-05-11. End date (EU): 2025-06-16. End date: 2025-06-17. Decision date: 2023-04-20. Results received: Yes. Last updated: 2025-06-16.
Decision dates by country: SI: 2023-04-21, IT: 2023-04-20, RO: 2023-04-28, HU: 2023-04-28, ES: 2023-04-24, FR: 2023-04-24, PL: 2023-04-24, NL: 2023-04-21, SK: 2023-04-21, BE: 2023-04-20, AT: 2023-04-28, GR: 2023-04-28, DE: 2023-04-28, BG: 2023-04-24

Condition(s): Atopic Dermatitis
Product: Placebo for AMG 451, Rocatinlimab

Primary endpoint: Whether or not a participant has clear or almost clear skin at week 24 based on vIGA-AD., Whether or not a participant’s eczema is 75% better at week 24 compared to the start of the study based on EASI.
Endpoint(s): Achieving EASI 75 at week 16, Achieving vIGA-AD 0/1 at week 16, Achieving from baseline in weekly average of daily worst pruritus numeric rating scale (NRS) score at week 16 in subjects with baseline weekly average of daily worst pruritus NRS score, Achieving from baseline in weekly average of daily worst pruritus NRS score at week 24 in subjects with baseline weekly average of daily worst pruritus NRS score, Achieving ≥ 90% reduction from baseline in EASI score (EASI 90) at week 24, Change from baseline in weekly average of daily AD skin pain NRS score at week 24, Achieving vIGA-AD response with presence of only barely perceptible erythema or vIGA-AD 0 response at week 24, Achieving a Facial AD Severity Score of clear at week 24 for subjects with facial AD at baseline, Achieving a Hand AD Severity Score of clear at week 24 for subjects with hand AD at baseline

Source: https://euclinicaltrials.eu/ctis-public/view/2022-501585-22-00